EU clinical trial 2025-522809-38-00: Continuous antibiotic infusion in children
Sponsor: Pirkanmaan hyvinvointialue (Hospital/Clinic/Other health care facility). Phase: Therapeutic confirmatory (Phase III). Countries: Finland (ongoing, recruiting).
Therapeutic area(s): Diseases [C] - Bacterial Infections and Mycoses [C01]
Gender: Female, Male. Age: 0-17 years. Enrolment: 150.
Status: Ongoing, recruiting. Start date (EU): 2026-04-21. Decision date: 2026-02-16. Results received: No. Last updated: 2026-03-16.

Condition(s): Infection disease
Product: Cloxacillin Navamedic 2 g injektio-/infuusiokuiva-aine liuosta varten, Benzylpenicillin Fresenius Kabi 1,2 g (2 milj. IU) injektio-/infuusiokuiva-aine liuosta varten, Piperacillin/Tazobactam Kalceks 2 g/0,25 g infuusiokuiva-aine, liuosta varten, Vancosan 500 mg, Infuusiokuiva-aine, liuosta varten

Primary endpoint: Duration of hospital stay / fever / antibiotic treatment, Readmission to hospital, Possible relapse (defined separately for each patient case)

Source: https://euclinicaltrials.eu/ctis-public/view/2025-522809-38-00